EU clinical trial 2023-504545-31-00: AN OPEN-LABEL, MULTICENTER, PHASE 1a/1b STUDY OF IGM-8444 AS A SINGLE AGENT AND IN COMBINATION IN SUBJECTS WITH RELAPSED, REFRACTORY, OR NEWLY DIAGNOSED CANCERS
Protocol code: IGM-8444-001
Sponsor: IGM Biosciences Inc. (Pharmaceutical company). Phase: Human Pharmacology (Phase I)- First administration to humans. Countries: Spain (ended), France (ended).
Therapeutic area(s): Diseases [C] - Neoplasms [C04]
Gender: Female, Male. Age: 18-64 years, 65+ years. Enrolment: 22.
Status: Ended. Start date (EU): 2023-11-23. End date (EU): 2024-11-04. End date: 2024-11-05. Decision date: 2023-10-23. Results received: No. Last updated: 2024-09-30.
Decision dates by country: ES: 2023-10-24, FR: 2023-10-23

Condition(s): colorectal cancer

Source: https://euclinicaltrials.eu/ctis-public/view/2023-504545-31-00